EU clinical trial 2024-512506-25-00: Rituximab-induced remission in CIDP (ReCIX study)
Sponsor: Amsterdam UMC Stichting (Hospital/Clinic/Other health care facility). Phase: Therapeutic confirmatory (Phase III). Countries: Netherlands (ongoing, recruiting).
Therapeutic area(s): Phenomena and Processes [G] - Immune system processes [G12]; Diseases [C] - Nervous System Diseases [C10]
Gender: Female, Male. Age: 18-64 years, 65+ years. Enrolment: 102.
Status: Ongoing, recruiting. Start date (EU): 2024-10-07. Decision date: 2024-08-15. Results received: No. Last updated: 2026-03-05.

Condition(s): Chronic inflammatory demyelinating polyneuropathy (CIDP)
Product: Rixathon 500 mg concentrate for solution for infusion

Primary endpoint: Remission at 52 weeks after start of RTX, i.e., no need of additional treatment after RTX treatment.
Endpoint(s): Stability on treatment at 104 weeks of follow-up.

Source: https://euclinicaltrials.eu/ctis-public/view/2024-512506-25-00